EU clinical trial 2025-523071-34-00: Adductor canal and IPACK (infiltration between the popliteal artery and the capsule of the knee) blocks versus genicular nerves block for total knee arthroplasty: A randomized clinical trial
Protocol code: ADIPGEN
Sponsor: Fundacio De Recerca Clinic Barcelona-Institut D’Investigacions Biomediques August Pi I Sunyer (Laboratory/Research/Testing facility). Phase: Therapeutic use (Phase IV). Countries: Spain (authorised, recruitment pending).
Therapeutic area(s): Diseases [C] - Musculoskeletal Diseases [C05]
Gender: Female, Male. Age: 18-64 years, 65+ years. Enrolment: 64.
Status: Authorised, recruitment pending. Decision date: 2026-02-06. Results received: No. Last updated: 2026-02-06.

Condition(s): Knee Osteoarthritis
Product: Adrenalina B. Braun 1 mg/ml Solución Inyectable, Ropivacaína B. Braun 2 mg/ml solución inyectable y para perfusión EFG

Primary endpoint: The Numerical Rating Scale (NRS) for pain.
Endpoint(s): Opioid consumption measured in morphine equivalents in milligrams., Range mobility measured by active and passive Range of Motion (ROM) Assessment., Quality of recovery 15 (QoR 15 questionnare)., Evaluate NRS at 0, 12 and 48h postoperatively.

Source: https://euclinicaltrials.eu/ctis-public/view/2025-523071-34-00